EU clinical trial 2024-518134-92-00: A Study to Learn How a Tablet Compared with an IV Infusion of the Study Medicine Called Vepdegestrant is Taken up into the Blood in Healthy Adults.
Protocol code: C4891037
Sponsor: Pfizer Inc. (Pharmaceutical company). Phase: Human Pharmacology (Phase I)- Other. Countries: Netherlands (ended).
Therapeutic area(s): Diseases [C] - Neoplasms [C04]
Gender: Female, Male. Age: 18-64 years, 65+ years. Enrolment: 10.
Status: Ended. Start date (EU): 2025-04-02. End date (EU): 2025-06-13. End date: 2025-06-14. Decision date: 2025-03-10. Results received: No. Last updated: 2025-03-10.

Condition(s): ER+/HER2- breast cancer

Source: https://euclinicaltrials.eu/ctis-public/view/2024-518134-92-00